EU clinical trial 2024-516597-30-00: The FibroCAN study. Mineralocorticoid receptor antagonist treatment for diabetic cardiovascular autonomic neuropathy
Sponsor: Steno Diabetes Center Copenhagen (Hospital/Clinic/Other health care facility). Phase: Therapeutic exploratory (Phase II). Countries: Denmark (ongoing, recruiting).
Therapeutic area(s): Diseases [C] - Nervous System Diseases [C10]
Gender: Female, Male. Age: 18-64 years, 65+ years. Enrolment: 100.
Status: Ongoing, recruiting. Start date (EU): 2025-05-02. Decision date: 2024-11-20. Results received: No. Last updated: 2026-04-07.

Condition(s): Diabetic cardiovascular autonomic neuropathy
Product: BAY 94-8862, Finerenone, Matching filmcoated placebo tablets will be provided by Bayer (see 2024-516258-23-00), Finerenone

Primary endpoint: The CART E/I ratio (by the Vagustm device)
Endpoint(s): Cardiovascular reflex tests: R/S ratio, Valsalva manoeuvre (CARTs), HRV indices (SDNN, RMSSD, Low and high-frequency power) (by the Vagustm device), Fibrosis markers (serum PRO-C6 and C3M assessed by ELISA), Fibrosis markers in skin biopsies (Pro-C6 and C3M by immunostaining (Only week 0, 36, 78)

Source: https://euclinicaltrials.eu/ctis-public/view/2024-516597-30-00